EU clinical trial 2024-518932-34-00: Effect of metyrapone on cardiovascular risk factors in patients with adrenal incidentalomas and subclinical/mild Cushing's syndrome
Protocol code: GR-MET-19
Sponsor: Azienda Ospedaliero-Universitaria Di Bologna IRCCS Istituto Di Ricerca E Di Cura A Carattere Scientifico (Hospital/Clinic/Other health care facility). Phase: Therapeutic use (Phase IV). Countries: Italy (ongoing, recruiting).
Therapeutic area(s): Diseases [C] - Hormonal diseases [C19]
Gender: Female, Male. Age: 18-64 years, 65+ years. Enrolment: 50.
Status: Ongoing, recruiting. Start date (EU): 2020-09-22. Decision date: 2024-11-27. Results received: No. Last updated: 2025-02-20.

Condition(s): patients with adrenal incidentalomas and subclinical/mild Cushing’s syndrome
Product: Cormeto 250 mg capsule molli

Primary endpoint: The primary endpoint of the study is the reduction of the number and/or the dose of antihypertensive drugs after 12 months of treatment with Metyrapone, while keeping blood pressure within pre-fixed target range (>100/60 mmHg e <130/85 mmHg)

Source: https://euclinicaltrials.eu/ctis-public/view/2024-518932-34-00